EU clinical trial 2023-506538-56-00: A Phase 2 Study to Evaluate the Efficacy and Safety of Pembrolizumab plus Investigational Agents in Combination with Etoposide and Cisplatin or Carboplatin for the First-Line Treatment of Participants with Extensive-Stage Small Cell Lung Cancer (KEYNOTE-B99)
Protocol code: MK-3475-B99
Sponsor: Merck Sharp & Dohme LLC (Pharmaceutical company). Phase: Therapeutic exploratory (Phase II). Countries: Poland (ended), Hungary (ended), Spain (ended), Italy (ended), Austria (ended).
Therapeutic area(s): Diseases [C] - Neoplasms [C04]
Gender: Female, Male. Age: 18-64 years, 65+ years. Enrolment: 76.
Status: Ended. Start date (EU): 2021-08-12. End date (EU): 2025-06-20. End date: 2025-06-23. Decision date: 2024-02-01. Results received: Yes. Last updated: 2025-06-17.
Decision dates by country: PL: 2024-02-14, IT: 2024-05-31, AT: 2024-02-05, ES: 2024-02-02, HU: 2024-02-01

Condition(s): First-line treatment of participants with extensive-stage small cell lung cancer
Product: Lenvatinib, Lenvatinib, KEYTRUDA 25 mg/mL concentrate for solution for infusion, MK-4830, ETOPOSIDE, Lenvatinib, CISPLATIN, boserolimab, CARBOPLATIN

Primary endpoint: Objective Response Rate (ORR) as Assessed by Blinded Independent Central Review (BICR) per Response Evaluation Criteria in Solid Tumors Version 1.1 (RECIST 1.1), Six-Month Progression-Free Survival (PFS) as Assessed by BICR per RECIST 1.1
Endpoint(s): Duration of Response (DOR) as Assessed by BICR per RECIST 1.1, PFS as Assessed by BICR per RECIST 1.1, Overall Survival (OS), Percent Change From Baseline in Tumor Size as Assessed by BICR, Number of Participants Who Experienced an Adverse Event (AE), Number of Participants Who Discontinued Study Treatment Due to an AE, Change From Baseline in the European Organization for Research and Treatment of Cancer Quality of Life Questionnaire C30 (EORTC QLQ-C30) Global Health Status/Quality of Life Scale (Items 29 and 30) at Week 19

Source: https://euclinicaltrials.eu/ctis-public/view/2023-506538-56-00